EU clinical trial 2023-508655-39-00: A Phase I/II Study of NMS-03592088, a FLT3, KIT and CSF1R Inhibitor, in Patients with Relapsed or Refractory AML or CMML
Protocol code: MKIA-088-001
Sponsor: Nerviano Medical Sciences S.r.l. (Pharmaceutical company). Phase: Phase I and Phase II (Integrated)- First administration to humans. Countries: France (ended), Spain (ended), Italy (ended).
Therapeutic area(s): Diseases [C] - Neoplasms [C04]
Gender: Female, Male. Age: 18-64 years, 65+ years. Enrolment: 143.
Status: Ended. Start date (EU): 2019-02-13. End date (EU): 2024-08-29. Decision date: 2023-12-14. Results received: Yes. Last updated: 2024-01-22.
Decision dates by country: ES: 2023-12-14, FR: 2023-12-19, IT: 2024-01-22

Condition(s): Acute Myeloid Leukemia (AML) or Chronic Myelomonocytic Leukemia(CMML) relapsed or refractory

Primary endpoint: Phase I • Drug related first-cycle dose limiting toxicities (DLTs) Phase II • FLT3-ITD mut AML: Composite Complete Remission (CRc) Rate, i.e. Complete Remission (CR) + Complete Remission with Incomplete Hematologic Recovery (CRi), as defined by the Investigators based on the 2022 European LeukemiaNet (ELN) recommendations

Source: https://euclinicaltrials.eu/ctis-public/view/2023-508655-39-00